EU clinical trial 2023-503828-13-00: A Randomized, Double-blind, Placebo-controlled, Crossover Study of Atrasentan in Subjects with IgA Nephropathy on Sodium-glucose Cotransporter-2 Inhibitors (SGLT2i) (The ASSIST study)
Protocol code: CEXV811A12201
Sponsor: Novartis Pharma AG (Pharmaceutical company). Phase: Therapeutic exploratory (Phase II). Countries: Spain (ended).
Therapeutic area(s): Diseases [C] - Immune System Diseases [C20]; Diseases [C] - Digestive System Diseases [C06]
Gender: Female, Male. Age: 18-64 years, 65+ years. Enrolment: 10.
Status: Ended. Start date (EU): 2023-12-12. End date (EU): 2025-08-06. End date: 2025-10-29. Decision date: 2023-10-30. Results received: Yes. Last updated: 2025-11-07.

Condition(s): Nephrology
Product: Matching placebo film-coated round tablets, atrasentan, DAPAGLIFLOZIN

Primary endpoint: The change in proteinuria (UPCR from a 24-hour urine collection) from Baseline to Week 12
Endpoint(s): In Treatment Period 2, the change in proteinuria (UPCR from a 24 hour urine collection) from Baseline to Week 24

Source: https://euclinicaltrials.eu/ctis-public/view/2023-503828-13-00